EU clinical trial 2022-502367-37-00: A phase I study of [177Lu]Lu-FF58 in patients with advanced solid tumors
Protocol code: CAAA604A12101
Sponsor: Novartis Pharma AG (Pharmaceutical company). Phase: Phase I and Phase II (Integrated)- First administration to humans. Countries: Netherlands (ended), Italy (ended), Spain (ended).
Therapeutic area(s): Diseases [C] - Neoplasms [C04]
Gender: Female, Male. Age: 18-64 years, 65+ years. Enrolment: 55.
Status: Ended. Start date (EU): 2024-11-29. End date (EU): 2024-12-13. End date: 2024-12-14. Decision date: 2023-07-28. Results received: No. Last updated: 2024-12-09.
Decision dates by country: IT: 2023-08-01, ES: 2023-08-01, NL: 2023-07-28

Condition(s): Recurrent glioblastoma multiforme (GBM), Locally advanced unresectable or metastatic pancreatic ductal adenocarcinoma (PDAC), Locally advanced unresectable or metastatic gastroesophageal adenocarcinoma (GEA)

Source: https://euclinicaltrials.eu/ctis-public/view/2022-502367-37-00